EU clinical trial 2024-518633-28-00: H1-antihistaminE treatment in combiNation with immunotHerapy in pAtieNts with advanced non small cell lung canCEr: A single- center phase II trial-ENHANCE
Protocol code: ENHANCE
Sponsor: Medical University Of Vienna (Educational Institution). Phase: Therapeutic exploratory (Phase II). Countries: Austria (authorised, recruiting).
Therapeutic area(s): Diseases [C] - Neoplasms [C04]
Gender: Female, Male. Age: 18-64 years, 65+ years. Enrolment: 9.
Status: Authorised, recruiting. Start date (EU): 2022-10-13. Decision date: 2024-12-10. Results received: No. Last updated: 2024-12-10.

Condition(s): Advanced non small lung cancer
Product: Allegra 120 mg Filmtabletten

Primary endpoint: Objective response rate according to RECIST 1.1., ORR; defined as complete or partial response at any timepoint during study period.
Endpoint(s): Secondary Endpoint: Progression-free survival (PFS), Overall survival (OS). Exploratory Endpoint: Safety & tolerability of fexofenadine in terms of haematologic and nonhaematologic side effects as assessed by the investigators. Quality of life (QoL) with focus on sleeping behavior in patients receiving fexofenadine assessed by the Pittsburgh Sleep Quality Index (PSQI), EORTC QLQ-c30 questionnaire and Lung Cancer Symptom Scale (LCSS). Analysis of predictive factors for the enhancement of immunoth

Source: https://euclinicaltrials.eu/ctis-public/view/2024-518633-28-00